EU clinical trial 2024-519972-21-00: Diagnostic yield of Endoscopic aspiration of duodenopancreatic juice after secretin stimulation (ADPJ-secr-) vs endoscopic ultrasound-guided fine needle aspiration (EUS-FNA) for molecular analysis of intraductal papillary mucinous intraductal neoplasia (IPMN)
Protocol code: RESCUE
Sponsor: Fundacio De Recerca Clinic Barcelona-Institut D’Investigacions Biomediques August Pi I Sunyer (Laboratory/Research/Testing facility). Phase: Therapeutic confirmatory (Phase III). Countries: Spain (authorised, recruitment pending).
Therapeutic area(s): Analytical, Diagnostic and Therapeutic Techniques and Equipment [E] - Diagnosis [E01]
Gender: Female, Male. Age: 18-64 years, 65+ years. Enrolment: 140.
Status: Authorised, recruitment pending. Decision date: 2025-01-14. Results received: No. Last updated: 2025-01-14.

Condition(s): Pancreatic cancer, Intraductal papillary mucinous intraductal neoplasia
Product: Chirhostim

Primary endpoint: Proportion of patients with IPMN with GNAS and KRAS mutations in intracystic fluid obtained by EUS-FNA versus pancreatic juice obtained by ADPJ-secr after both techniques.
Endpoint(s): 1. Proportion of patients with IPMN with Tp53 mutations in samples obtained by EUS-FNA versus AJPD-sec after performing both techniques, in the subgroup of patients undergoing pancreatic resection within 12 months after inclusion in the study., 2. DNA concentration expressed in ng/μl in samples obtained by EUSFNA versus ADPJ-secr after performing both techniques., 3. Proportion of suitable samples obtained by the two techniques under study (ADPJ-secr and EUS-FNA) for molecular analysis. * A sample is defined as suitable when it is read by the Qubit fluorometer, which only detects full double-stranded DNA suitable for molecular analysis., 4. Proportion of patients undergoing pancreatic resection with a pathological diagnosis of IPMN who have mutations in GNAS and/or KRAS in samples obtained by EUS-FNA versus ADPJ-secr within 12 months of study entry., 5. Proportion of patients undergoing pancreatic resection without a pathological diagnosis of IPMN who do not have GNAS and/or KRAS mutations in samples obtained by EUS-FNA versus ADPJ-secr within 12 months of study entry., 6. Proportion of patients undergoing pancreatic resection with Tp53 mutations in samples obtained by both techniques under study (ADPJsecr vs EUS-FNA) who have advanced neoplasia in the surgical resection specimen after surgery performed within 12 months after study inclusion., 7. Proportion of patients undergoing pancreatic resection without Tp53 mutations in samples obtained by both techniques under study (ADPJsecr vs EUS-FNA) who do not have advanced neoplasia in the surgical resection specimen after surgery performed within 12 months after inclusion in the study., 8.1. To evaluate the association between mutational status (GNAS/KRAS mutated versus GNAS/KRAS non-mutated [wild type]) in samples obtained by both techniques under study (EUS-FNA vs AJPD-sec) in relation to the following clinical-analytical variables: age, sex, toxic habits (smoking, chronic alcohol consumption), 8.2. Comorbidities, history of acute pancreatitis, previous diagnosis of chronic pancreatitis, first-degree family history of pancreatic cancer, duration since IPMN diagnosis, morphological type of IPMN (IPMN-MC, IPMN-MP, mixed IPMN), blood levels of amylase, lipase, creatinine, total bilirubin, AST/ALT, GGT/ALP, creatinine, hemoglobin, platelets, CA 19-9, CEA, and glycated hemoglobin., 9. To evaluate the association between mutational status in samples obtained by both techniques under study in relation to the following morphological characteristics of the lesion obtained by EUS: diameter of the largest cystic lesion, maximum diameter of the main pancreatic duct, type of pancreatic duct dilation, lesion location, presence of cystic lesion, mural nodules, signs of chronic pancreatitis, intraductal calcifications, pancreatic atrophy, and final EUS diagnosis of the lesion., 10. To evaluate the association between mutational status in samples obtained by both techniques under study in relation to the following technical characteristics of EUS-FNA and AJPD-sec: access route for FNA, punctured lesion, location of the punctured lesion, needle gauge used, type of needle used, number of passes, amount of fluid obtained by both techniques, type of endoscope used for AJPD-sec., 11. To evaluate the association between mutational status (GNAS/KRAS mutated versus GNAS/KRAS non-mutated [wild type]) in samples obtained by both techniques under study (EUS-FNA vs AJPD-sec) in relation to the following morphological characteristics of the intracystic fluid: filamentous or non-filamentous., 12. To evaluate the association between mutational status (GNAS/KRAS mutated versus GNAS/KRAS non-mutated [wild type]) in samples obtained by both techniques under study (EUS-FNA vs AJPD-sec) in relation to the following biochemical characteristics: CEA, glucose, and amylase., 13. To evaluate the association between mutational status (GNAS/KRAS mutated versus GNAS/KRAS non-mutated [wild type]) in samples obtained by both techniques under study (EUS-FNA vs AJPD-sec) in relation to the following cytological characteristics of the intracystic fluid: mucus-secreting cells, mucin, and final cytological diagnosis., 14. Proportion of patients in whom AJPD-sec could be performed with a gastroscope with a cap without the need for rescue with a duodenoscope., 15. Evaluate whether any of the variables assessed in objectives 8, 9, 10, 11, 12, or 13 predict the inability to obtain a pancreatic juice sample using a cap-fitted gastroscope after performing both techniques under study., 16. Proportion of patients with adverse effects related to the techniques under study (EUS-FNA and AJPD-secr) defined according to the criteria of the American Society of Gastrointestinal Endoscopy (PB Cotton, et al. Gastrointest Endosc, 2010) at 24 hours and 7 days after the procedures., 17. Evaluate whether any of the variables assessed in objectives 8, 9, 10, 11, 12, or 13 predict the occurrence of adverse effects associated with the techniques under study at 24 hours and 7 days after the procedures., 18. Proportion of patients with Serious Adverse Events at 24 hours and 7 days after the procedures under study.

Source: https://euclinicaltrials.eu/ctis-public/view/2024-519972-21-00